EU clinical trial 2023-507914-28-00: A Phase 2/3, Multicenter, Randomized Study of Raludotatug Deruxtecan (R-DXd), a CDH6-directed Antibody-drug Conjugate, in Subjects with Platinum-resistant, High-grade Ovarian, Primary Peritoneal, or Fallopian Tube Cancer
Protocol code: DS6000-109
Sponsor: Daiichi Sankyo Inc. (Pharmaceutical company). Phase: Phase II and Phase III (Integrated). Countries: Italy (ongoing, recruitment ended), Spain (ongoing, recruitment ended), Poland (ongoing, recruitment ended), Germany (ongoing, recruitment ended), Greece (ongoing, recruitment ended), Czechia (ongoing, recruitment ended), France (ongoing, recruitment ended), Portugal (ongoing, recruitment ended), Finland (ongoing, recruitment ended).
Therapeutic area(s): Diseases [C] - Neoplasms [C04]
Gender: Female. Age: 18-64 years, 65+ years. Enrolment: 344.
Status: Ongoing, recruitment ended. Start date (EU): 2024-06-19. Decision date: 2024-05-23. Results received: No. Last updated: 2026-07-23.
Decision dates by country: FR: 2024-05-27, PL: 2024-05-27, FI: 2024-11-04, CZ: 2024-05-23, ES: 2024-05-23, GR: 2024-05-23, IT: 2024-05-24, PT: 2024-05-24, DE: 2024-05-27

Condition(s): Platinum-resistant, high-grade serous ovarian cancer (OVC),high-grade endometrioid OVC, primary peritoneal cancer, or fallopian tube cancer
Product: DOXORUBICIN HYDROCHLORIDE, LIPOSOMAL, TOPOTECAN, PACLITAXEL, Raludotatug Deruxtecan

Primary endpoint: Phase 2: ORR as assessed by BICR based on RECIST version 1.1 Phase 3: PFS as assessed by BICR based on RECIST version 1.1 or death due to any reason

Source: https://euclinicaltrials.eu/ctis-public/view/2023-507914-28-00